EU clinical trial 2023-506329-12-00: Traitement des Idées Suicidaires aux urgences par adjonction de Protoxyde d’Azote (PROTORISC pilote)
Sponsor: Centre Hospitalier Regional Universitaire De Tours (Hospital/Clinic/Other health care facility). Phase: Therapeutic exploratory (Phase II). Countries: France (ongoing, recruiting).
Therapeutic area(s): Psychiatry and Psychology [F] - Mental Disorders [F03]; Psychiatry and Psychology [F] - Psychological Phenomena [F02]
Gender: Female, Male. Age: 18-64 years. Enrolment: 30.
Status: Ongoing, recruiting. Start date (EU): 2025-05-14. Decision date: 2024-04-23. Results received: No. Last updated: 2024-04-23.

Condition(s): Treatment of suicidal ideation
Product: KALINOX 50%/50%, gaz medicinal comprime, Medical Air

Primary endpoint: Intensité/sévérité des idées suicidaires évaluées par l’échelle d’Idéation suicidaire de Beck (SSI).
Endpoint(s): Idées suicidaires évaluées par : Échelle SSI administrée également à 24h, 48h, J7 et J30 Échelle Columbia d’évaluation de la gravité du Risque suicidaire (C-SSRS) administrée à J0 et J7, Symptômes dépressifs mesurés par : Hétéro-évaluation par la « Montogomery-Asberg Depression Rating Scale » (MADRS) administrée à J0 et J7, Symptômes dépressif mesurés par : Auto-questionnaire « Patient Health Questionnaire » PHQ-9 administré à J0, 4h, 24h, 48h et J7., Intensité de l’anxiété mesurée par l’échelle « State and Trait Anxiety Inventory » (STAI) passée entre J0, 4h, 24h, 48h et J7., Amélioration globale mesurée par le changement du score de l’échelle « Clinical Global Impression - Improvement » (CGI) entre J0 et 4h, 24h, 48h et J7., Passage à l’acte suicidaire dans le mois qui suit l’inclusion, Consommation de psychotrope à visée anxiolytique ou sédative entre H0 et H4.

Source: https://euclinicaltrials.eu/ctis-public/view/2023-506329-12-00